EU clinical trial 2023-504905-36-00: Intralesional Steroid Injections to Prevent Refractory Strictures in Patients with Esophageal Atresia
Protocol code: NL65364.078.18
Sponsor: Erasmus Universitair Medisch Centrum Rotterdam (Erasmus MC) (Hospital/Clinic/Other health care facility). Phase: Phase III and phase IV (Integrated). Countries: Netherlands (ongoing, recruiting), Sweden (ongoing, recruiting), Finland (ongoing, recruiting), France (authorised, recruitment pending), Denmark (ongoing, recruiting).
Therapeutic area(s): Diseases [C] - Digestive System Diseases [C06]
Gender: Female, Male. Age: 0-17 years. Enrolment: 110.
Start date (EU): 2024-01-11. Decision date: 2024-01-11. Results received: No. Last updated: 2026-04-17.
Decision dates by country: NL: 2024-01-15, DK: 2024-01-17, FR: 2024-02-05, SE: 2024-01-11, FI: 2024-01-12

Condition(s): Strictures after esophageal atresia repair
Product: Kenacort-A 10, suspensie voor injectie 10 mg/ml, Kenacort-T 40 mg/ml injektionsvätska, suspension

Primary endpoint: The total number of dilatations within 28 days interval needed per patient during the study period, i.e. from the day of the study dilatation until 6 months later.

Source: https://euclinicaltrials.eu/ctis-public/view/2023-504905-36-00